EU clinical trial 2023-507018-29-00: Double-Blind, Randomized, Placebo-Controlled, Phase 1b, Pharmacodynamic Trial of TEV-56192 Following a Single Intravenous Administration in Healthy Participants
Protocol code: TV56192-PD-10191
Sponsor: Teva Branded Pharmaceutical Products R&D Inc. (Pharmaceutical company). Phase: Human Pharmacology (Phase I)- Other. Countries: Denmark (ended).
Therapeutic area(s): Diseases [C] - Skin and Connective Tissue Diseases [C17]
Gender: Female, Male. Age: 18-64 years, 65+ years. Enrolment: 48.
Status: Ended. Start date (EU): 2024-03-05. End date (EU): 2024-11-22. Decision date: 2024-02-22. Results received: No. Last updated: 2024-08-06.
Decision dates by country: DK: 2024-03-05

Condition(s): Pruritus

Source: https://euclinicaltrials.eu/ctis-public/view/2023-507018-29-00